EU clinical trial 2025-523690-41-00: A phase III, Multicentre, Open-Label, Chronic dosing, Extension Study to Evaluate the Long-term Safety of Tozorakimab in Participants with Chronic Obstructive Pulmonary Disease (COPD) With a History of COPD Exacerbations (ROMEO)
Protocol code: D9180C00015
Sponsor: AstraZeneca AB (Pharmaceutical company). Phase: Therapeutic confirmatory (Phase III). Countries: France (ongoing, recruiting).
Therapeutic area(s): Diseases [C] - Respiratory Tract Diseases [C08]
Gender: Female, Male. Age: 18-64 years, 65+ years. Enrolment: 82.
Status: Ongoing, recruiting. Start date (EU): 2026-05-04. Decision date: 2025-12-24. Results received: No. Last updated: 2026-02-03.
Decision dates by country: FR: 2026-02-03

Condition(s): Chronic Obstructive Pulmonary Disease (COPD)

Primary endpoint: Adverse events, laboratory assessments. Assessments related to adverse events include: • Occurrence/frequency • Relationship to IMP as assessed by Investigator • Intensity • Seriousness • Death • Adverse events leading to discontinuation of IMP • Other significant AEs

Source: https://euclinicaltrials.eu/ctis-public/view/2025-523690-41-00